EU clinical trial 2024-519901-36-00: ETOP 27-23 ARCH – A randomised phase III trial of adjuvant cemiplimab in patients with resected stage II-IIIA NSCLC who have not received prior adjuvant chemotherapy.
Protocol code: ETOP 27-23 ARCH
Sponsor: ETOP IBCSG Partners Foundation (Laboratory/Research/Testing facility). Phase: Therapeutic confirmatory (Phase III). Countries: France (authorised, recruitment pending), Estonia (authorised, recruiting), Spain (ongoing, recruiting), Austria (authorised, recruitment pending), Italy (ongoing, recruiting), Germany (authorised, recruitment pending), Ireland (ongoing, recruiting).
Therapeutic area(s): Diseases [C] - Respiratory Tract Diseases [C08]; Diseases [C] - Neoplasms [C04]
Gender: Female, Male. Age: 18-64 years, 65+ years. Enrolment: 300.
Start date (EU): 2025-12-17. Decision date: 2025-10-08. Results received: No. Last updated: 2026-07-22.
Decision dates by country: EE: 2025-10-13, AT: 2025-10-13, FR: 2025-10-10, ES: 2025-10-09, IE: 2025-10-10, IT: 2025-10-08, DE: 2025-10-17

Condition(s): Patients with resected stage II-IIIA non-small cell lung cancer (NSCLC) with PD-L1 expression ≥1%
Product: LIBTAYO 350 mg concentrate for solution for infusion.

Primary endpoint: Disease free survival (in patients with tumours with centrally confirmed PD-L1 expression of ≥1%)
Endpoint(s): Overall survival, Incidence, nature and severity of adverse events according to CTCAE v5

Source: https://euclinicaltrials.eu/ctis-public/view/2024-519901-36-00